EU clinical trial 2024-517875-19-00: A pilot study to assess the impact of ABCB1 on the neuropharmacokinetics of the weak ABCB1 substrate [11C]metoclopramide
Sponsor: Medical University Of Vienna (Educational Institution). Phase: Human Pharmacology (Phase I)- First administration to humans. Countries: Austria (ongoing, recruiting).
Therapeutic area(s): Phenomena and Processes [G] - Biological Phenomena [G16]
Gender: Female, Male. Age: 18-64 years, 65+ years. Enrolment: 85.
Status: Ongoing, recruiting. Start date (EU): 2017-10-12. Decision date: 2025-01-15. Results received: No. Last updated: 2025-01-15.

Condition(s): Investigation in healthy volunteers and dementia patients (Alzheimers disease)

Source: https://euclinicaltrials.eu/ctis-public/view/2024-517875-19-00